EU clinical trial 2024-511435-10-00: Is CT 01 safe to use alone or combined with Everolimus for inoperable advanced liver cancer?
Protocol code: CT‑01-CD-1
Sponsor: Captor Therapeutics S.A. (Pharmaceutical company). Phase: Human Pharmacology (Phase I)- First administration to humans. Countries: France (ongoing, recruiting), Spain (ongoing, recruiting), Germany (ongoing, recruiting).
Therapeutic area(s): Diseases [C] - Neoplasms [C04]
Gender: Female, Male. Age: 18-64 years, 65+ years. Enrolment: 154.
Status: Ongoing, recruiting. Start date (EU): 2025-04-30. Decision date: 2024-12-16. Results received: No. Last updated: 2026-06-04.
Decision dates by country: ES: 2024-12-16, DE: 2024-12-17, FR: 2024-12-16

Condition(s): Hepatocellular Carcinoma

Source: https://euclinicaltrials.eu/ctis-public/view/2024-511435-10-00